EU clinical trial 2022-501575-12-00: C3601008 - A PHASE 2A MULTICENTER, OBSERVER-BLINDED, RANDOMIZED 2 ARM STUDY TO INVESTIGATE PHARMACOKINETICS, SAFETY, TOLERABILITY AND EFFICACY OF INTRAVENOUS AZTREONAM-AVIBACTAM ± METRONIDAZOLE COMPARED TO BEST AVAILABLE THERAPY (BAT) IN PEDIATRIC PARTICIPANTS 9 MONTHS TO LESS THAN 18 YEARS OF AGE WITH SERIOUS GRAM-NEGATIVE BACTERIAL INFECTIONS INCLUDING COMPLICATED INTRA-ABDOMINAL INFECTION
Protocol code: C3601008
Sponsor: Pfizer Inc. (Pharmaceutical company). Phase: Therapeutic exploratory (Phase II). Countries: Hungary (ongoing, recruiting), Spain (ongoing, recruiting), Greece (ongoing, recruiting), Czechia (ended).
Therapeutic area(s): Diseases [C] - Bacterial Infections and Mycoses [C01]
Gender: Female, Male. Age: 0-17 years. Enrolment: 20.
Start date (EU): 2023-04-24. Decision date: 2022-12-20. Results received: No. Last updated: 2025-10-15.
Decision dates by country: GR: 2022-12-20, ES: 2022-12-22, HU: 2022-12-21, CZ: 2023-01-09

Condition(s): Hospital-Acquired Pneumonia, Ventilator-Associated Pneumonia, complicated gram-negative bacterial infections, Sepsis, Blood Stream Infection, Intra-abdominal Infection, Urinary Tract Infection
Product: Aztreonam and Avibactam (1.5g/0.5g) Powder for Concentrate for Solution for Infusion, AMIKACIN, GENTAMICIN, Aztreonam, AMOXICILLIN AND ENZYME INHIBITOR, Metronidazole, Aztreonam, Metronidazole 500mg/100ml Solution for Infusion, TEICOPLANIN, COLISTIN, Metronidazole 500 mg / 100 ml Intravenous Infusion, MEROPENEM, AMPICILLIN, IMIPENEM AND ENZYME INHIBITOR, LINEZOLID, Avibactam 600 mg Powder for Concentrate for Solution for Infusion, MOXIFLOXACIN, Aztreonam, PIPERACILLIN AND ENZYME INHIBITOR, CLINDAMYCIN, VANCOMYCIN

Primary endpoint: PK parameters including CL, Cmax, Cmin, AUC and t1/2, Plasma concentrations of ATM and AVI on Day 1 and at steady state (Day 2 or later), AEs and SAEs, Adverse events leading to discontinuation and adverse events resulting in death, Assessments of liver and renal functions tests at baseline, while on treatment and after end of treatment
Endpoint(s): Clinical outcomes at EOIV, EOT, and TOC., Microbiological response at EOIV, EOT, and TOC.

Source: https://euclinicaltrials.eu/ctis-public/view/2022-501575-12-00